EU clinical trial 2023-510382-10-00: Metformin for the prolongation of pregnancy in preterm preeclampsia: the PI-NL trial
Protocol code: U1111-1303-8616
Sponsor: Amsterdam UMC (Hospital/Clinic/Other health care facility). Phase: Therapeutic confirmatory (Phase III). Countries: Netherlands (ongoing, recruiting).
Therapeutic area(s): Diseases [C] - Female Urogenital Diseases and Pregnancy Complications [C13]
Gender: Female. Age: 18-64 years. Enrolment: 180.
Status: Ongoing, recruiting. Start date (EU): 2025-08-25. Decision date: 2024-09-24. Results received: No. Last updated: 2026-05-18.

Condition(s): HELLP syndrome, Preterm preeclampsia, Hypertensive disorders of pregnancy
Product: Metformine HCl 500 mg Teva, filmomhulde tabletten, Microcrystalline cellulose

Primary endpoint: Gestational prolongation (in days)
Endpoint(s): Combined endpoint of maternal adverse outcome, consisting of maternal death (death during pregnancy or within 42 days of delivery), eclampsia, pulmonary edema, severe renal impairment, cerebrovascular accident, placental abruption, and/or liver hematoma or rupture., Combined endpoint of fetal adverse outcome, consisting of intrauterine fetal death (IUFD, including intrapartum death), suboptimal fetal condition based on the heart rate pattern on the CTG (as judged by the treating clinician), and/or fetal growth restriction (FGR), Combined endpoint of neonatal adverse outcome, consisting of neonatal death (within 28 days of birth), intraventricular hemorrhage (grade III or IV), retinopathy of prematurity requiring treatment, necrotizing enterocolitis (grade II or higher), bronchopulmonary dysplasia, neonatal sepsis, and/or cystic periventricular leukomalacia (grade II or higher)

Source: https://euclinicaltrials.eu/ctis-public/view/2023-510382-10-00